EU clinical trial 2023-506823-28-00: EMPIRE : Targeting MDM2 and PD1 in tumors with tertiary lymphoid structures
Protocol code: IB 2023-02
Sponsor: Institut Bergonie (Hospital/Clinic/Other health care facility). Phase: Therapeutic exploratory (Phase II). Countries: France (ended).
Therapeutic area(s): Diseases [C] - Neoplasms [C04]
Gender: Female, Male. Age: 18-64 years, 65+ years. Enrolment: 120.
Status: Ended. Start date (EU): 2024-06-14. End date (EU): 2024-07-01. Decision date: 2024-05-14. Results received: Yes. Last updated: 2024-06-14.

Condition(s): Adult patients with locally advanced/metastatic solid tumors
Product: BI 907828, Ezabenlimab, BI 907828, BI 907828

Primary endpoint: Disease control is defined as confirmed complete response (CR), unconfirmed complete response (CRu), confirmed partial response (PR), unconfirmed partial response (PRu) of any duration, or stable disease (SD) lasting for at least 24 weeks, as per RECIST v1.1. Disease control rate (DCR), defined as the proportion of patients with disease control lasting for at least 24 weeks since treatment onset, will be reported.
Endpoint(s): 1) a) Objective response defined as confirmed complete response (CR), unconfirmed complete response (Cru), confirmed partial response (PR) or unconfirmed partial response (PRu) as per RECIST v1.1. Objective response rate (ORR), defined as the proportion of patients with objective response will be assessed, based on centralized radiological review, within 24 weeks of treatment onset. Note that confirmation of claimed responses at least 4 weeks later is not required., 1) b) Duration of reponse (DoR) defined as the time from documentation of tumor response (CR, Cru, PR, PRu) to disease progression (as per RECIST V1.1). Response assessement will be performed according to centralized radiological review. Note that confirmation of claimed responses at least 4 weeks later is not required., 1) c) Progression-free survival (PFS) defined as the time from the first day of treatment to the first documented disease progression (as per RECIST v1.1) or death (due to any cause), whichever occurs first. Median PFS, 1- year PFS rate will be reported for each cohort. Response assessement will be performed according to centralized radiological review., 1) d) ORR, DoR and PFS defined above, will also be evaluated according to the local radiological assessment (performed by the investigator)., 1) e) Overall survival defined as the time from the first day of treatment to death (due to any cause). Median OS, 1- year OS rate will be reported for each cohort., 2) For cohort A: as an exploratory way, secondary endpoints defined above will be assessed in two subgroups of patients with altered/biomarker positive soft tissue sarcomas (MDM2 status amplified or not)., 3)The safety and tolerability of the combination: Occurence of adverse events (AEs) and Serious adverse events (SAEs). Events will be graded using the Common Terminology Criteria for Adverse Events (CTCAE) from the NCI v5.0. Both AEs and SAEs will be coded according to the standardized medical terminology MedDRA.

Source: https://euclinicaltrials.eu/ctis-public/view/2023-506823-28-00